EU clinical trial 2024-515523-11-00: A Phase 3 Randomized, Double-blind, Placebo-controlled Study to Evaluate the Efficacy, Safety, and Tolerability of Maridebart Cafraglutide in Adult Participants With Type 2 Diabetes Mellitus Who Have Obesity or Are Overweight (MARITIME-2)
Protocol code: 20210184
Sponsor: Amgen Inc. (Pharmaceutical company). Phase: Therapeutic confirmatory (Phase III). Countries: Hungary (ongoing, recruitment ended), Italy (ongoing, recruitment ended), Czechia (ongoing, recruitment ended), Germany (ongoing, recruitment ended), Bulgaria (ongoing, recruitment ended), Poland (ongoing, recruitment ended).
Therapeutic area(s): Diseases [C] - Nutritional and Metabolic Diseases [C18]
Gender: Female, Male. Age: 18-64 years, 65+ years. Enrolment: 420.
Status: Ongoing, recruitment ended. Start date (EU): 2025-06-09. Decision date: 2025-06-03. Results received: No. Last updated: 2026-04-09.
Decision dates by country: IT: 2025-06-05, BG: 2025-06-09, PL: 2025-06-08, HU: 2025-06-10, CZ: 2025-06-03, DE: 2025-06-05

Condition(s): Chronic Weight Management
Product: AMG 133, Placebo for AMG 133 (maridebart cafraglutide)

Primary endpoint: Percent change from baseline in body weight at week 72
Endpoint(s): Change from baseline in waist circumference (cm) at week 72, Achieving ≥ 5% reduction in body weight from baseline at week 72, Achieving ≥ 10% reduction in body weight from baseline at week 72, Achieving ≥ 15% reduction in body weight from baseline at week 72, Change from baseline in SBP (mmHg) at week 72, Percent change from baseline in fasting triglycerides at week 72, Change from baseline in fasting plasma glucose (mg/dL) at week 72, Change from baseline in hemoglobin A1c (HbA1c) (%, mmol/mol) at week 72, Achieving HbA1c < 7% at week 72, Change from baseline in the Impact of Weight on Quality of Life-Lite Clinical Trials Version (IWQOL-Lite-CT) Physical Function Composite Score at week 72

Source: https://euclinicaltrials.eu/ctis-public/view/2024-515523-11-00